EU clinical trial 2023-503547-33-00: A study to learn how safe the study drug BAY 2416964 (AhR inhibitor) in combination with the treatment pembrolizumab is, how this combination affects the body, the maximum amount that can be given, how it moves into, through and out of the body and its action against advanced solid cancers in adults
Sponsor: Bayer AG (Pharmaceutical company). Phase: Human Pharmacology (Phase I)- Other. Countries: Italy (ended).
Therapeutic area(s): Diseases [C] - Neoplasms [C04]
Gender: Female, Male. Age: 18-64 years, 65+ years. Enrolment: 15.
Status: Ended. Start date (EU): 2023-07-12. End date (EU): 2025-01-20. End date: 2025-01-21. Decision date: 2024-05-03. Results received: No. Last updated: 2025-01-24.

Condition(s): Advanced solid tumors

Source: https://euclinicaltrials.eu/ctis-public/view/2023-503547-33-00